EU clinical trial 2024-510985-17-00: A Phase 2, Open-Label, Randomized Study to Assess the Efficacy and Safety of Zolbetuximab (IMAB362) in Combination with Nab-Paclitaxel and Gemcitabine (Nab-P + GEM) as First Line Treatment in Subjects with Claudin 18.2 (CLDN18.2) Positive, Metastatic Pancreatic Adenocarcinoma
Protocol code: 8951-CL-5201
Sponsor: Astellas Pharma Global Development Inc. (Pharmaceutical company). Phase: Therapeutic exploratory (Phase II). Countries: Ireland (ended), Spain (ongoing, recruitment ended), Italy (ongoing, recruitment ended), France (ongoing, recruitment ended).
Therapeutic area(s): Diseases [C] - Neoplasms [C04]
Gender: Female, Male. Age: 18-64 years, 65+ years. Enrolment: 113.
Start date (EU): 2019-03-14. Decision date: 2024-06-14. Results received: No. Last updated: 2026-06-30.
Decision dates by country: IT: 2024-06-19, IE: 2024-06-14, ES: 2024-06-18, FR: 2024-07-10

Condition(s): First Line Treatment in Subjects with Claudin 18.2 (CLDN18.2) Positive, Metastatic Pancreatic Adenocarcinoma.
Product: GEMCITABINE, PACLITAXEL, ASP8951

Primary endpoint: ● Confirm RP2D as assessed by DLTs (Safety Lead-in Phase) ● Safety and tolerability as measured by AEs, laboratory test results, vital signs, ECGs and ECOG performance status. ● OS, defined as the time from the date of randomization until the date of death from any cause
Endpoint(s): ● PFS, defined as the time from the date of randomization until the date of radiological PD per RECIST 1.1 by local investigator evaluation, or death from any cause, whichever is earliest, ● ORR, defined as the proportion of subjects who have a best overall response of CR or PR as assessed by local investigator evaluation per RECIST 1.1, Pharmacokinetic parameters of zolbetuximab, Nab-P and GEM (AUCinf, AUCinf [%extrap], AUClast, Cmax, Ctrough, tmax, t1/2, tlast, CL, Vz, as appropriate, DCR, defined as the proportion of subjects who have a best overall response of CR, PR or stable disease (SD) as assessed by local investigator evaluation per RECIST 1.1, ● DOR, defined as the time from the date of the first response (CR/PR) until the date of PD as assessed by local investigator evaluation per RECIST 1.1 or date of death from any cause, whichever is earlies, Time to worsening of pancreatic pain and GHS/QoL as measured by QLQ-C30, QLQ-PAN26, and PGIS as key HRQOL endpoints, HRQoL, as collected viameasured by EORTC QLQ-C30, EORTC QLQPAN26 (including remaining domains besides pancreatic pain), EORTC QLQ-C30 (including remaining domains besides GHS/QoL), EQ-5D-5L, PGIS and PGIC questionnaires, Serum CA19-9 change from baseline, Immunogenicity of zolbetuximab as measured by the frequency of anti-drug antibody (ADA) positive subjects.

Source: https://euclinicaltrials.eu/ctis-public/view/2024-510985-17-00